EU clinical trial 2025-520479-25-00: A Phase 3, Multicenter, Double-Blinded, Randomized Study to Evaluate REGN7508, a Factor XI Monoclonal Antibody, Versus Acetylsalicylic Acid for Prophylaxis of Symptomatic Venous Thromboembolism After Elective Total Knee Arthroplasty (ROXI-ASPEN)
Protocol code: R7508-DVT-24120
Sponsor: Regeneron Pharmaceuticals Inc. (Pharmaceutical company). Phase: Therapeutic confirmatory (Phase III). Countries: Greece (authorised, recruitment pending), Italy (authorised, recruitment pending), Spain (authorised, recruitment pending).
Therapeutic area(s): Diseases [C] - Hemic and Lymphatic Diseases [C15]
Gender: Female, Male. Age: 18-64 years, 65+ years. Enrolment: 208.
Status: Authorised, recruitment pending. Decision date: 2026-04-01. Results received: No. Last updated: 2026-07-27.
Decision dates by country: GR: 2026-04-01, IT: 2026-04-07, ES: 2026-07-27

Condition(s): Symptomatic Venous Thromboembolism (VTE)
Product: ACETYLSALICYLIC ACID, REGN7508, Placebo for Acetylsalicylic Acid, Placebo for REGN7508

Primary endpoint: Incidence of the composite endpoint of symptomatic VTE and VTE-related death
Endpoint(s): Incidence of confirmed symptomatic Deep Vein Thrombosis (DVT), Incidence of confirmed Pulmonary Embolism (PE), Incidence of VTE-related death, Time to first event of the composite endpoint of symptomatic VTE and VTE-related death, Time to first event of confirmed symptomatic DVT, Time to first event of confirmed PE, Time to VTE-related death, Incidence of the composite endpoint of major bleeding and Clinically Relevant Non-Major (CRNM) bleeding, Incidence of minor bleeding, Incidence of Treatment-Emergent Adverse Events (TEAEs), Severity of TEAEs, Incidence of Anti-drug Antibody (ADA) to REGN7508, Magnitude of ADA to REGN7508, Concentrations of REGN7508

Source: https://euclinicaltrials.eu/ctis-public/view/2025-520479-25-00